EU clinical trial 2022-501858-11-00: Remifentanil for endotracheal intubation in neonates: a dose-finding trial.
Protocol code: BC-09897
Sponsor: Universitair Ziekenhuis Gent (Hospital/Clinic/Other health care facility). Phase: Therapeutic confirmatory (Phase III). Countries: Belgium (ongoing, recruiting).
Therapeutic area(s): Analytical, Diagnostic and Therapeutic Techniques and Equipment [E] - Anesthesia and Analgesia [E03]
Gender: Female, Male. Age: 0-17 years. Enrolment: 50.
Status: Ongoing, recruiting. Start date (EU): 2023-12-26. Decision date: 2023-01-20. Results received: No. Last updated: 2025-11-21.

Condition(s): Hemodynamic stable term and preterm neonates requiring semi-elective endotracheal intubation.
Product: Ultiva 1 mg poeder voor concentraat voor oplossing voor injectie / infusie, NaCl 0,9 % B. Braun, oplossing voor injectie

Primary endpoint: Successful outcome is defined as adequate intubation with satisfactory sedation. Following each procedure: intubating conditions are graded immediately by the intubator with a scoring system based on criteria for good clinical research practice (GCRP) by Viby-Mogensen. Each assessment domain is allocated a score of 1-4. Good quality of intubation was defined as a score of ≤ 2 on each of the 5 items., The level of sedation is assessed with a sedation score (adopted from the study of Naulaers et al) performed by rubbing the sole of the subject’s foot and judging the motor reaction to that stimulus (1 = spontaneous movement; 2 = movement on slight touch; 3 = movement in reaction to firm stimulus; 4 = no movement).
Endpoint(s): safety end points: During the intubation procedure: predefined side effects such as bradycardia (heart rate less than 100 bpm), hypotension, respiratory depression, and chest wall rigidity are reviewed.., efficacy end points: ease of bag-mask ventilation and time to successful intubation, additional end points: time to return of spontaneous ventilation ; incidence of intraventricular hemorrhage ; blood gas values ; need for rescue medication

Source: https://euclinicaltrials.eu/ctis-public/view/2022-501858-11-00